EU clinical trial 2024-518808-43-00: Pharmacokinetics of antibiotics in cerebrospinal fluid of children with malignant brain tumors – a pilot study
Sponsor: Medical University Of Vienna (Educational Institution). Phase: Human Pharmacology (Phase I)- First administration to humans. Countries: Austria (ongoing, recruiting).
Therapeutic area(s): Diseases [C] - Bacterial Infections and Mycoses [C01]
Gender: Female, Male. Age: 0-17 years, 18-64 years. Enrolment: 60.
Status: Ongoing, recruiting. Start date (EU): 2018-10-22. Decision date: 2024-12-11. Results received: No. Last updated: 2024-12-11.

Condition(s): brain tumors
Product: Augmentin 875 mg/125 mg Filmtabletten, Ciprofloxacin Noridem 2 mg/ml Infusionslösung, Eusaprim - Tabletten, Cefotaxim-MIP 1 g – Pulver zur Herstellung einer Injektions- oder Infusionslösung, Fomicyt 40 mg/ml Pulver zur Herstellung einer Infusionslösung, Cefuroxim „Astro“ - Trockenstechampulle, Ciproxin 500 mg Filmtabletten, Ceftriaxon Kabi 1 g Pulver zur Herstellung einer Injektions- /Infusionslösung, Linezolid Kabi 2 mg/ml Infusionslösung, Vancomycin Hikma 1000 mg - Pulver für ein Konzentrat zur Herstellung einer Infusionslösung, Meropenem Hikma 1g Pulver zur Herstellung einer Injektions-/Infusionslösung, Gentamicin Sandoz 80 mg – Ampullen

Primary endpoint: Area under the concentration-time curve (AUC) from 0 to last observed concentration (AUC0-τ), AUC from 0 to 24 hours (AUC0-24), concentration during therapy and at defined time points after end of therapy, Pharmacokinetic parameters describing rate/extent of distribution from plasma into CSF
Endpoint(s): ratio of the CSF AUC0-24 to the minimum inhibitory concentration (AUC0-24/MIC), percentage of the dosing interval during which drug concentrations in CSF exceed the MIC (%T>MIC), ratio of the peak CSF concentration to the MIC (Cmax/MIC), Determination of target attainment for relevant pathogens

Source: https://euclinicaltrials.eu/ctis-public/view/2024-518808-43-00